EU clinical trial 2022-501759-95-00: An exploratory, prospective, multicenter, randomized, double blind, placebo + sham device controlled, study to assess the safety, usability, and initial efficacy of the ViXe combination for intravesical administration of XEOMIN® in the treatment of female patients with idiopathic overactive bladder (OAB).
Protocol code: ViXe-CLP-0002
Sponsor: Vensica Medical Ltd. (Pharmaceutical company). Phase: Therapeutic exploratory (Phase II). Countries: Portugal (ended).
Therapeutic area(s): Diseases [C] - Male Urogenital Diseases [C12]; Diseases [C] - Female Urogenital Diseases and Pregnancy Complications [C13]
Gender: Female. Age: 18-64 years, 65+ years. Enrolment: 50.
Status: Ended. Start date (EU): 2023-06-05. End date (EU): 2024-02-01. Decision date: 2023-03-23. Results received: Yes. Last updated: 2023-03-23.

Condition(s): Overactive bladder (OAB)
Product: Xeomin 200 unidades pó para solução injetável, Xeomin placebo

Primary endpoint: Safety: Incidence of drug and device related adverse events from treatment to 12-weeks post treatment., Usability: Physician, Subject and Technician’s questionnaires.
Endpoint(s): Mean change from baseline in the average number of daily Urgency Urinary Incontinence (UUI) Episodes at 6 and 12-weeks post treatment based on a 3-day voiding diary., Mean change from Baseline in the average number of daily voiding episodes at 6 and 12-weeks post treatment based on a 3-day voiding diary., Mean Change from baseline in Urinary grade 3 or 4 Urgency Episodes at 6 and 12-weeks post treatment based on a 3-day voiding diary., Mean change from baseline in Number of large leaks at 6 and 12- weeks post treatment based on a 3-day voiding diary., Change from baseline in QAB-q total score at week 12., Mean change from baseline in the average number of daily Nocturia episodes at 6 and 12-weeks post treatment based on a 3-day voiding diary.

Source: https://euclinicaltrials.eu/ctis-public/view/2022-501759-95-00